EU clinical trial 2023-504835-42-00: A Phase 2a, Multicenter, Randomized, Double-blind, Placebo-controlled, Parallel-group Study to Evaluate the Efficacy, Safety and Tolerability of JTT-861 Administered for 12 Weeks in Subjects with Heart Failure with Reduced Ejection Fraction (POWER-HF)
Protocol code: AT861-G-22-002
Sponsor: Akros Pharma Inc. (Pharmaceutical company). Phase: Therapeutic exploratory (Phase II). Countries: Poland (ended), Spain (ended), Romania (ended), Bulgaria (ended), Czechia (ended).
Therapeutic area(s): Diseases [C] - Cardiovascular Diseases [C14]
Gender: Female, Male. Age: 18-64 years, 65+ years. Enrolment: 422.
Status: Ended. Start date (EU): 2024-02-29. End date (EU): 2026-05-11. End date: 2026-05-19. Decision date: 2024-02-12. Results received: No. Last updated: 2026-03-10.
Decision dates by country: ES: 2024-02-12, CZ: 2024-02-13, RO: 2024-02-19, BG: 2024-02-16, PL: 2024-02-16

Condition(s): Heart Failure (Heart Failure with Reduced Ejection Fraction)
Product: JTT-861, Placebo tablet for JTT-861

Primary endpoint: Efficacy Parameters • Change from baseline to end of treatment (EOT) in: o LVEF as assessed by two-dimensional echocardiography (2D-echo) o Left ventricular end-systolic volume (LVESV) index as assessed by 2D-echo o Left ventricular end-diastolic volume (LVEDV) index as assessed by 2D-echo, Efficacy Parameters • Change from baseline to end of treatment (EOT) in: o Left atrial volume (LAV) as assessed by 2D-echo o NT-pro-BNP o Kansas City Cardiomyopathy Questionnaire (KCCQ) scores, Pharmacokinetic (PK) Parameters • JTT-861 trough plasma concentrations at Weeks 4, 8 and 12 • JTT-861 plasma concentrations (post-dose) at Weeks 2, 4 and 8, Safety Parameters • Number of subjects with adverse events (AEs), change from baseline in safety laboratory, vital signs and 12-lead electrocardiogram (ECG) parameters.
Endpoint(s): Exploratory Efficacy Parameters • Change from baseline to EOT in: o eGFR o Cystatin C o Urine albumin-to-creatinine ratio (ACR) o Hemoglobin A1c (HbA1c) and plasma glucose, Exploratory Efficacy Parameters • Change from baseline to EOT in: o Tricuspid annular plane systolic excursion (TAPSE) as assessed by 2D-echo o Fractional area change (FAC) as assessed by 2D-echo o Right ventricular (RV) longitudinal strain as assessed by 2D-echo o Tricuspid regurgitation peak gradient (TRPG) as assessed by 2D-echo, Exploratory Pharmacodynamic (PD) Parameters • Change from baseline to EOT in branched-chain amino acids (BCAAs: isoleucine, leucine and valine) and alanine plasma concentrations

Source: https://euclinicaltrials.eu/ctis-public/view/2023-504835-42-00